EU clinical trial 2024-510908-37-00: A Phase III, Randomized, Open-Label, Multicenter Study Evaluating the Efficacy and Safety of Divarasib Versus Sotorasib or Adagrasib in Patients with previously treated KRAS G12C-Positive Advanced or Metastatic Non-Small Cell Lung Cancer
Protocol code: BO45217
Sponsor: F. Hoffmann-La Roche AG (Pharmaceutical company). Phase: Therapeutic confirmatory (Phase III). Countries: France (ongoing, recruitment ended), Spain (ongoing, recruitment ended), Portugal (ongoing, recruitment ended), Germany (ongoing, recruitment ended), Poland (ongoing, recruitment ended), Greece (ongoing, recruitment ended), Belgium (ongoing, recruitment ended), Finland (ongoing, recruitment ended), Italy (ongoing, recruitment ended), Sweden (ended), Netherlands (ongoing, recruitment ended), Austria (ongoing, recruitment ended), Denmark (ongoing, recruitment ended).
Therapeutic area(s): Diseases [C] - Neoplasms [C04]
Gender: Female, Male. Age: 18-64 years, 65+ years. Enrolment: 250.
Start date (EU): 2024-08-28. Decision date: 2024-08-19. Results received: No. Last updated: 2026-07-13.
Decision dates by country: SE: 2024-08-22, FI: 2024-08-20, PL: 2024-08-26, GR: 2024-08-20, AT: 2024-08-26, NL: 2024-08-22, BE: 2024-08-19, IT: 2024-08-21, PT: 2024-08-20, DE: 2024-08-20, FR: 2024-08-21, ES: 2024-08-23, DK: 2024-08-19

Condition(s): KRAS G12C-Positive Advanced or Metastatic Non-Small Cell Lung Cancer (NSCLC)

Primary endpoint: 1. Progression-free survival (PFS)
Endpoint(s): 1. Overall survival (OS), 2. Confirmed Objective response, 3. Time to confirmed deterioration (TTCD) on the EORTC QLQ-C30 dyspnea item and the physical functioning scale, and the cough scale of the QLQ-LC13 scales, 4. Duration of response (DOR), 5. Incidence and severity of adverse events, with severity determined according to the NCI CTCAE v5.0 grading scale, 6. Change from baseline in selected vital signs and ECG parameters, 7. Change from baseline in selected clinical laboratory test results, 8. Presence, frequency of occurrence, severity, and/or degree of interference with daily function of symptomatic treatment toxicities (diarrhea, nausea, vomiting, anorexia, alopecia, dyspnea, cough, constipation, myalgia, headache, and rash/acne) as assessed through use of the NCI PRO-CTCAE, 9. Change from baseline in diarrhea, nausea, vomiting, anorexia, alopecia, dyspnea, cough, constipation, myalgia, headache, and rash/acne as assessed through use of the NCI PRO-CTCAE, 10. Frequency of participants’ response of the degree they are troubled with treatment symptoms, as assessed through use of the single-item EORTC Item List (IL46), 11. Change from baseline in cough, chest pain, dyspnea, physical and role functioning, and GHS/QoL at each timepoint as assessed through use of the EORTC QLQ-LC13 and QLQ-C30, 12. TTCD on the EORTC QLQ-C30 role functioning and GHS/QoL scales and TTCD on the chest pain scale of the QLQ-LC13 scales

Source: https://euclinicaltrials.eu/ctis-public/view/2024-510908-37-00